EU clinical trial 2023-507432-20-00: A First-in-Human Clinical Study with ABBV-CLS-579 alone and in combination in Patients with Advanced Tumor Cancers
Protocol code: M20-124
Sponsor: AbbVie Deutschland GmbH & Co. KG (Pharmaceutical company). Phase: Human Pharmacology (Phase I)- First administration to humans. Countries: Spain (ended), France (ended).
Therapeutic area(s): Diseases [C] - Neoplasms [C04]
Gender: Female, Male. Age: 18-64 years, 65+ years. Enrolment: 150.
Status: Ended. Start date (EU): 2022-12-10. End date (EU): 2025-08-21. End date: 2025-08-22. Decision date: 2023-10-20. Results received: No. Last updated: 2025-03-24.
Decision dates by country: ES: 2023-10-20, FR: 2023-11-13

Condition(s): Metastatic or locally advanced tumors

Source: https://euclinicaltrials.eu/ctis-public/view/2023-507432-20-00